EU clinical trial 2025-524077-16-00: Maintenance AVElumab after SECond line platinum-based chemotherapy for metastatic urothelial carcinoma: AVESEC trial - GOIRC-02-2025
Protocol code: GOIRC-02-2025
Sponsor: G.O.I.R.C. Gruppo Oncologico Italiano Di Ricerca Clinica (Patient organisation/association). Phase: Therapeutic exploratory (Phase II). Countries: Italy (authorised, recruitment pending).
Therapeutic area(s): Diseases [C] - Neoplasms [C04]
Gender: Female, Male. Age: 18-64 years. Enrolment: 144.
Status: Authorised, recruitment pending. Decision date: 2026-05-12. Results received: No. Last updated: 2026-05-12.

Condition(s): metastatic urothelial carcinoma
Product: AVELUMAB

Primary endpoint: Comparison between treatment arms will be performed using a one-sided log-rank test, and the treatment effect will be quantified using the hazard ratio (HR) estimated from a Cox proportional hazards model, along with corresponding confidence intervals.
Endpoint(s): Investigator-assessed PFS, Objective response rates (ORR), Duration of response (DR), Disease control rate (DCR) assessed per RECIST v1.1 by BICR and investigator., Safety: Adverse events (AEs) and laboratory abnormalities as graded by Common Terminology Criteria for Adverse Events (CTCAE) v.5.0, Patient-Reported Outcomes: patient-reported bladder cancer symptom, functioning, global quality of life (QOL), and Time to Deterioration (TTD) using the NCCN- FACT FBlSI; health status using the EQ-5D., Overall Survival (OS), 1-year PFS based on BICR assessment per RECIST v1.1.

Source: https://euclinicaltrials.eu/ctis-public/view/2025-524077-16-00